EU clinical trial 2025-523726-40-00: A PHASE III, OPEN-LABEL, SINGLE-ARM, MULTI-CENTER STUDY TO EVALUATE THE SAFETY AND USE OF AN ON-BODY DELIVERY SYSTEM FOR THE SUBCUTANEOUS HOME ADMINISTRATION OF OCRELIZUMAB IN PATIENTS WITH MULTIPLE SCLEROSIS
Protocol code: CN46182
Sponsor: F. Hoffmann-La Roche AG (Pharmaceutical company). Phase: Therapeutic confirmatory (Phase III). Countries: Spain (ongoing, recruiting), France (ongoing, recruiting), Poland (ongoing, recruiting), Italy (ongoing, recruiting).
Therapeutic area(s): Diseases [C] - Immune System Diseases [C20]; Diseases [C] - Nervous System Diseases [C10]
Gender: Female, Male. Age: 18-64 years. Enrolment: 54.
Status: Ongoing, recruiting. Start date (EU): 2026-06-24. Decision date: 2026-06-24. Results received: No. Last updated: 2026-07-09.
Decision dates by country: IT: 2026-06-24, ES: 2026-06-26, PL: 2026-06-29, FR: 2026-06-26

Condition(s): Multiple Sclerosis
Product: Ocrevus, Ocrelizumab

Primary endpoint: Occurrence of successful self/lay caregiver administration of the Week 1 dose
Endpoint(s): Occurrence of successful self/lay caregiver administration at home of the Week 24 and Week 48 doses, Occurrence and nature of injection reactions (severity, treatment, need for intervention by a healthcare professional, outcome), Occurrence and severity of adverse device effect (ADEs) and anticipated serious adverse device effect (ASADEs), Occurrence of unanticipated serious adverse device effect (USADEs), Occurrence of device deficiency (DDs) that could lead to serious adverse device effect serious adverse device effect (SADEs)

Source: https://euclinicaltrials.eu/ctis-public/view/2025-523726-40-00